EU clinical trial 2024-517123-39-00: MOVE-IT: MOdel-Informed Precision Dosing of Ustekinumab and VEdolizumab in Inflammatory Bowel Disease - An Independant Randomized Controlled Trial
Protocol code: 2024-517123-39-00
Sponsor: Odense University Hospital (Hospital/Clinic/Other health care facility). Phase: Therapeutic use (Phase IV). Countries: Denmark (ongoing, recruiting).
Therapeutic area(s): Diseases [C] - Digestive System Diseases [C06]
Gender: Female, Male. Age: 18-64 years, 65+ years. Enrolment: 166.
Status: Ongoing, recruiting. Start date (EU): 2025-12-15. Decision date: 2025-04-13. Results received: No. Last updated: 2026-03-24.

Condition(s): crohns disease, Ulcerative colitis
Product: USTEKINUMAB, VEDOLIZUMAB

Primary endpoint: The fraction of patients in steroid-free remission ((for CD defined by PRO2 ≤ 4, for UC defined by PRO2 = 0) AND a fecal calprotectin ≤200) at the end of the observation period (48 weeks).
Endpoint(s): The fraction of the observation period (48 weeks) where the disease is in steroid-free remission (for CD defined by PRO2 ≤ 4, for UC defined by PRO2 = 0) AND a fecal calprotectin ≤200., The financial costs associated with the two treatment strategies over the observation period (48 weeks), including expenditure on medicines (both expenditure on the purchase of medicines and expenditure on the administration of medicines), expenses for doctor visits / visits to a nurse, possibly expenses for hospitalization, possibly expenses for surgery, possibly expenses for sick leave and possibly expenses for early retirement., Endoscopic healing of the mucosa assessed after 48 weeks (for CD assessed by Simple Endoscopic Score for Crohn's Disease (SES-CD) <3; and for UC assessed on the basis of the Ulcerative Colitis Endoscopic Index of Severity (UCEIS) ≤1. If disease is primarily located in the small intestine, MRI or capsule endoscopy will be used instead, and assessed by the simplified MaRIA score or Lewis score, respectively., Quality of life assessed by SIBDQ at inclusion and end of treatment., Quality of life assessed by EQ-5D-5L and transferred to QALY. The price of QALYs will also be measured., The portion of the observational period wherein the patient’s disease is in clinical remission, assessed as the portion of the observational period in which the disease is in steroid-free remission according to Simplified Clinical Activity Index (SCCAI) for ulcerative colitis and Harvey-Bradshaw Index (HBI) for Crohn’s disease., The inflammatory burden during the observational period, assessed by CRP, albumin, hemoglobin, leukocyte-measurements and fecal-calprotectin., Drug concentration analysis expenses., Drug expenses, The proportion of patients switching to another drug during the study period., Consumption of steroids, defined as redeemed prescriptions from the apothecary. Surgery related to IBD., Fatigue assessed by VAS-F difference between patients in the intervention and control group, The diseases impact on work productivity and performance of daily activities assessed by difference in WPAI scores and changes in scores between patients in the intervention and control group

Source: https://euclinicaltrials.eu/ctis-public/view/2024-517123-39-00